EU clinical trial 2024-511847-24-00: ADJUBIL - A Phase II study of immunotherapy with durvalumab and tremelimumab in combination with capecitabine or without capecitabine in ADJUvant situation for BILiary tract cancer
Protocol code: ADJUBIL
Sponsor: Frankfurter Institut Fuer Klinische Krebsforschung IKF GmbH (Pharmaceutical company). Phase: Therapeutic exploratory (Phase II). Countries: Germany (ended).
Therapeutic area(s): Diseases [C] - Neoplasms [C04]
Gender: Female, Male. Age: 18-64 years, 65+ years. Enrolment: 40.
Status: Ended. Start date (EU): 2022-05-23. End date (EU): 2025-02-20. Decision date: 2024-09-20. Results received: Yes. Last updated: 2025-01-09.

Condition(s): Biliary tract cancer
Product: IMFINZI 50 mg/mL concentrate for solution for infusion., CAPECITABINE, TREMELIMUMAB

Primary endpoint: Recurrence free survival at 12 months (RFS@12)
Endpoint(s): Recurrence free survival (RFS), Overall survival (OS), Safety (AEs, impact of liver function, use of subsequent therapies), QoL, Exploratory endpoints: Collection of tissue and blood samples for future evaluation of predictive biomarkers for RFS and OS.

Source: https://euclinicaltrials.eu/ctis-public/view/2024-511847-24-00